EU clinical trial 2024-513200-34-00: Safety of Lanreotide 120 mg ATG in combination with Metformin in patients with progressive advanced Well-differentiated gastro-intestinal (GI) or lung carcinoids. A pilot, one-arm, open-label, prospective study: the MetNET-2 trial
Sponsor: Fondazione IRCCS Istituto Nazionale Dei Tumori (Hospital/Clinic/Other health care facility). Phase: Therapeutic exploratory (Phase II). Countries: Italy (ongoing, recruiting).
Therapeutic area(s): Diseases [C] - Neoplasms [C04]
Gender: Female, Male. Age: 18-64 years, 65+ years. Enrolment: 20.
Status: Ongoing, recruiting. Start date (EU): 2016-04-19. Decision date: 2024-06-03. Results received: No. Last updated: 2024-06-03.

Condition(s): advanced progressive gastro-intestinal or lung carcinoids
Product: IPSTYL “120 mg soluzione iniettabile in siringa preriempita”, METFORMINA TEVA 850 mg compresse rivestite con film

Primary endpoint: To evaluate the incidence of SAEs and AEs, physical examination output, laboratory tests results, and cardiologic assessment, during treatment study period.
Endpoint(s): To evaluate the efficacy of Lanreotide ATG 120 mg in combination with Metformin on the time to progression (TTP), defined as the time from first study drugs administration (Lanreotide 120 mg plus Metformin) to the first radiological or clinical or biochemical progression or tumor-related death, according to RECIST criteria vs 1.1., To evaluate the efficacy of Lanreotide ATG 120 mg in combination with Metformin on symptomatic response.

Source: https://euclinicaltrials.eu/ctis-public/view/2024-513200-34-00